EU clinical trial 2024-514789-38-00: Impact of levothyroxine on erectile function measured by the IIEF-15, EHS, PGIC and EDITS questionnaires in patients with hypothyroidism. Prospective, randomized controlled clinical trial with sildenafil 100
Protocol code: 457531
Sponsor: Asociacion Instituto De Investigacion Sanitaria Biobizkaia (Laboratory/Research/Testing facility). Phase: Therapeutic use (Phase IV). Countries: Spain (ended).
Therapeutic area(s): Diseases [C] - Hormonal diseases [C19]; Diseases [C] - Male Urogenital Diseases [C12]
Gender: Male. Age: 18-64 years, 65+ years. Enrolment: 90.
Status: Ended. End date (EU): 2025-12-01. Decision date: 2024-09-30. Results received: No. Last updated: 2024-12-23.

Condition(s): erectile function, hypothyroidism subclinic
Product: SILDENAFIL, LEVOTHYROXINE SODIUM

Primary endpoint: The evolution of the scores measured by the IIEF-15, EHS, PGIC and EDITS questionnaires throughout the baseline measurements, and at the 3-month post-treatment follow-up in the three study groups after the start of treatment

Source: https://euclinicaltrials.eu/ctis-public/view/2024-514789-38-00